EU clinical trial 2023-506359-68-00: A Multicenter Randomized Double-Blind Placebo-Controlled Phase 3 Study to Evaluate the Efficacy and Safety of Anifrolumab in Adult Patients with Active Proliferative Lupus Nephritis
Protocol code: IRIS, D3466C00001
Sponsor: Astrazeneca AB (Pharmaceutical company). Phase: Therapeutic confirmatory (Phase III). Countries: Italy (ongoing, recruitment ended), Germany (ongoing, recruitment ended), Belgium (ongoing, recruitment ended), France (ongoing, recruitment ended), Netherlands (ongoing, recruitment ended), Bulgaria (ended), Hungary (ongoing, recruitment ended), Poland (ongoing, recruitment ended).
Therapeutic area(s): Diseases [C] - Immune System Diseases [C20]
Gender: Female, Male. Age: 18-64 years, 65+ years. Enrolment: 69.
Start date (EU): 2022-04-08. Decision date: 2024-05-16. Results received: No. Last updated: 2026-08-06.
Decision dates by country: BG: 2024-05-17, DE: 2024-05-22, FR: 2024-05-16, PL: 2024-06-14, BE: 2024-05-17, HU: 2024-05-21, IT: 2024-05-21, NL: 2024-05-16

Condition(s): Active Proliferative Lupus Nephritis
Product: Anifrolumab Placebo, Saphnelo 300 mg concentrate for solution for infusion

Primary endpoint: "CRR at Week 52, ie, meeting all of the following: - UPCR ≤ 0.5 mg/mg - eGFR ≥ 60 mL/min/1.73 m2 or no decrease from baseline of ≥ 20%"
Endpoint(s): "Sustained OCS reduction, ie, meeting all of the following: - OCS dose of ≤ 7.5 mg/day prednisone or equivalent by Week 24 - Sustained OCS dose of ≤ 7.5 mg/day prednisone or equivalent from Week 24 through Week 52", "Time to sustained CRR, ie, meeting all of the following: - UPCR ≤ 0.5 mg/mg - eGFR ≥ 60 mL/min/1.73 m2 or no decrease from baseline of ≥ 20% (ie, time from first study intervention dose to achieving CRR that is sustained from that time point through Week 52)", Cumulative UPCR as determined by the standardized AUC from baseline up to and including Week 52., CRR at Week 24 (see definition above), Time to renal event as defined as any of the following: 1) ESKD, 2) doubling of serum creatinine, 3) renal worsening as evidenced by increased proteinuria and/or renal function impairment, or 4) renal disease treatment failure, or 5) death - through Week 76.

Source: https://euclinicaltrials.eu/ctis-public/view/2023-506359-68-00